EU clinical trial 2023-503906-35-00: A Phase I/II Study to Evaluate the Safety, Tolerability, Pharmacokinetics, Pharmacodynamics, and Efficacy of NXT007 in Persons with Severe or Moderate Hemophilia A
Protocol code: WP44714
Sponsor: F. Hoffmann-La Roche AG (Pharmaceutical company). Phase: Phase I and Phase II (Integrated)- Other. Countries: Italy (ongoing, recruiting), Poland (ongoing, recruiting), Spain (ongoing, recruiting).
Therapeutic area(s): Phenomena and Processes [G] - Chemical Phenomena [G02]; Diseases [C] - Hemic and Lymphatic Diseases [C15]; Diseases [C] - Congenital, Hereditary, and Neonatal Diseases and Abnormalities [C16]
Gender: Male. Age: 0-17 years, 18-64 years. Enrolment: 16.
Status: Ongoing, recruiting. Start date (EU): 2023-10-11. Decision date: 2023-09-15. Results received: No. Last updated: 2025-11-26.
Decision dates by country: PL: 2023-09-20, IT: 2023-09-19, ES: 2023-09-15

Condition(s): Severe or Moderate Hemophilia A with or without factor VIII inhibitors
Product: NXT007

Primary endpoint: 1. Incidence and severity of adverse events with severity determined according to National Cancer Institute Common Terminology Criteria for Adverse Events version 5 .0 (NCI CTCAE v5.0), 2. Change from baseline in selected clinical laboratory test results, 3. Change from baseline in vital signs and electrocardiogram (ECG) parameters
Endpoint(s): 1. Plasma concentration of NXT007 at specified timepoints and relevant pharmacokinetic (PK) parameters, 2. Prevalence of anti-drug antibodies (ADAs) at baseline and incidence of ADAs during the study, 3. Number and proportion of participants with anti-FVIII inhibitors (titer >= 0.6 BU/mL) at specified timepoints, 4. Number of bleeding events over time, 5. Annualized bleeding rate (ABR) for treated bleeds, all bleeds, treated spontaneous bleeds, and treated joint bleeds

Source: https://euclinicaltrials.eu/ctis-public/view/2023-503906-35-00